EU clinical trial 2023-509677-24-02: Effect of Modafinil on military observational performance and residual capacity of the Dutch Air Assault Brigade: a field trial
Protocol code: MoAAB
Sponsor: TNO Netherlands Organisation for applied scientific research (Laboratory/Research/Testing facility). Phase: Therapeutic exploratory (Phase II). Countries: Netherlands (ended).
Therapeutic area(s): Not possible to specify
Gender: Female, Male. Age: 18-64 years. Enrolment: 40.
Status: Ended. End date (EU): 2025-03-31. Decision date: 2024-08-26. Results received: No. Last updated: 2025-03-14.

Condition(s): Healthy participants

Source: https://euclinicaltrials.eu/ctis-public/view/2023-509677-24-02